EU clinical trial 2025-524385-18-00: A Randomised, Open-Label, Single-Centre, Study to Evaluate the Bioequivalence of Lanifibranor
Protocol code: 337HVPK24018
Sponsor: Inventiva (Pharmaceutical company). Phase: Human Pharmacology (Phase I)- Bioequivalence Study. Countries: France (ended).
Therapeutic area(s): Diseases [C] - Digestive System Diseases [C06]
Gender: Female, Male. Age: 18-64 years. Enrolment: 30.
Status: Ended. Start date (EU): 2026-02-11. End date (EU): 2026-05-26. Decision date: 2026-02-04. Results received: No. Last updated: 2026-02-04.

Condition(s): Non-alcoholic steatohepatitis

Source: https://euclinicaltrials.eu/ctis-public/view/2025-524385-18-00